EU clinical trial 2023-507441-29-00: RANDOMISED EVALUATION OF COVID-19 THERAPY (RECOVERY)
Sponsor: University Of Oxford (Educational Institution). Phase: Therapeutic confirmatory (Phase III). Countries: Italy (ongoing, recruiting), Netherlands (ongoing, recruiting), France (ongoing, recruiting), Belgium (ongoing, recruiting), Estonia (ongoing, recruiting), Portugal (ongoing, recruiting), Romania (ongoing, recruiting), Spain (ongoing, recruiting), Sweden (ongoing, recruiting).
Therapeutic area(s): Diseases [C] - Bacterial Infections and Mycoses [C01]; Diseases [C] - Virus Diseases [C02]; Diseases [C] - Respiratory Tract Diseases [C08]
Gender: Female, Male. Age: 18-64 years, 65+ years. Enrolment: 1590.
Status: Ongoing, recruiting. Start date (EU): 2024-02-29. Decision date: 2024-02-02. Results received: No. Last updated: 2026-06-23.
Decision dates by country: FR: 2024-02-02, IT: 2024-02-09, NL: 2024-02-05, BE: 2024-11-28, EE: 2024-11-28, PT: 2024-11-07, RO: 2025-01-17, ES: 2024-12-04, SE: 2024-12-09

Condition(s): Pneumonia, Pneumonia
Product: Xofluza 20 mg film-coated tablets, Tamiflu 75 mg hard capsules, Dexamethasone 3.3 mg/ml solution for injection, Hydrocortisone 100 mg, powder for solution for injection/infusion, Prednisolone 10mg Tablets, Dexamethasone Tablets BP 2.0mg

Primary endpoint: 28 day all-cause mortality, Time to discharge alive from hospital within 28 days (patients with influenza only)
Endpoint(s): Time to discharge alive from hospital within 28 days (patients without influenza), Progression to invasive mechanical ventilation (including extracorporeal membrane oxygenation) or death within 28 days

Source: https://euclinicaltrials.eu/ctis-public/view/2023-507441-29-00